EU clinical trial 2024-519537-29-00: A Phase I Study of BMS-986497 alone or in combination with Azacitidine (Aza) and Azacitidine plus Venetoclax (AZA+VEN) in relapsed or refractory (R/R) AML or MDS
Protocol code: CA235-0001
Sponsor: Bristol-Myers Squibb Services Unlimited Company (Pharmaceutical company). Phase: Human Pharmacology (Phase I)- First administration to humans. Countries: France (ended), Spain (ended).
Therapeutic area(s): Diseases [C] - Neoplasms [C04]
Gender: Female, Male. Age: 18-64 years, 65+ years. Enrolment: 35.
Status: Ended. Start date (EU): 2026-03-13. End date (EU): 2026-08-06. Decision date: 2025-09-26. Results received: No. Last updated: 2026-08-07.
Decision dates by country: ES: 2025-10-01, FR: 2025-09-26

Condition(s): Acute Myeloid Leukemia and Myelodysplastic Syndrome

Source: https://euclinicaltrials.eu/ctis-public/view/2024-519537-29-00